EU clinical trial 2022-500059-22-01: High-dosage fluoride toothpaste for root caries control (in situ): a randomized, controlled clinical trial
Sponsor: Aarhus University (Educational Institution). Phase: Therapeutic use (Phase IV). Countries: Denmark (ended).
Therapeutic area(s): Phenomena and Processes [G] - Digestive System and Oral Physiological Phenomena [G10]
Gender: Female, Male. Age: 18-64 years, 65+ years. Enrolment: 10.
Status: Ended. Start date (EU): 2023-03-24. End date (EU): 2024-04-22. Decision date: 2022-10-31. Results received: Yes. Last updated: 2024-01-07.

Condition(s): Phenomena and Processes (Fluoride in dental caries control)
Product: Duraphat, tandpasta, Toothpaste (cosmetic product), fluoride concentration: 1,450 ppm

Primary endpoint: Mineral loss / uptake in experimental bovine dental root slabs (in situ)
Endpoint(s): The fluoride concentration in saliva and biofilm (on the bovine dental root slabs)

Source: https://euclinicaltrials.eu/ctis-public/view/2022-500059-22-01